EU clinical trial 2022-502853-32-00: A Phase 1b/2, Double-Blind, Placebo-Controlled, Randomized, Parallel-Arm Study to Explore Safety, Pharmacokinetics, and Early Clinical Signal of Efficacy of DS-2325a in Patients with Netherton Syndrome
Protocol code: DS2325-119
Sponsor: Daiichi Sankyo Inc. (Pharmaceutical company). Phase: Phase I and Phase II (Integrated)- Other. Countries: France (ended).
Therapeutic area(s): Diseases [C] - Skin and Connective Tissue Diseases [C17]; Diseases [C] - Congenital, Hereditary, and Neonatal Diseases and Abnormalities [C16]
Gender: Female, Male. Age: 18-64 years. Enrolment: 12.
Status: Ended. Start date (EU): 2023-08-18. End date (EU): 2025-01-06. End date: 2025-01-07. Decision date: 2023-07-17. Results received: Yes. Last updated: 2024-10-15.

Condition(s): Netherton's Syndrome
Product: DS-2325a, SODIUM CHLORIDE SOLUTION 0.9%

Primary endpoint: Safety endpoints will be adverse events (AEs), including serious AEs (SAEs), injection site reactions (ISRs), physical examination findings, vital sign recordings (body temperature, blood pressure, heart rate, respiratory rate), results of safety laboratory analyses of blood and urine, and electrocardiogram (ECG) findings.
Endpoint(s): Endpoints descriptive of plasma PK properties will be PK parameters derived from population PK analysis, including, but not limited to, pre-dose trough concentration (Ctrough), AUCtau,ss, total body clearance (CL), and CL/F, and epidermis-to-dermis DS-2325a concentration ratio (Ked)., DS-2325a presence will be assessed in the skin if the optional skin biopsies will be available., Several endpoints for the assessment of efficacy (ECS), including, but not limited to IASI (including IASI-Erythema and IASI Scaling), Investigator Global Assessment (IGA) and patient-reported outcome (PRO) measures, such as Itch Numerical Rating Scale (NRS) scores and quality-of-life assessments obtained using the Skindex-29 and the Dermatology-Life-Quality-Index (DLQI) questionnaires., Anti-drug antibodies (ADAs) against DS-2325a will be the immunogenicity endpoint.

Source: https://euclinicaltrials.eu/ctis-public/view/2022-502853-32-00